EU clinical trial 2023-505571-78-00: EFFECT OF THE USE OF DAPAGLIFLOZIN IN DIURESIS, NATRIURIESIS AND IN ULTRAFILTRATION AND PERITONEAL ELIMINATION OF SODIUM, IN PATIENTS WITH REFRACTORY HEART FAILURE (DAPA-DP study)
Sponsor: Instituto de Investigacion Sanitaria Fundacion para la Investigacion del Hospital Clinico de Valencia-INCLIVA (Hospital/Clinic/Other health care facility). Phase: Therapeutic use (Phase IV). Countries: Spain (ongoing, recruiting).
Therapeutic area(s): Analytical, Diagnostic and Therapeutic Techniques and Equipment [E] - Therapeutics [E02]
Gender: Female, Male. Age: 18-64 years, 65+ years. Enrolment: 1.
Status: Ongoing, recruiting. Start date (EU): 2024-05-16. Decision date: 2023-09-01. Results received: No. Last updated: 2024-07-29.

Condition(s): REFRACTORY HEART FAILURE
Product: Forxiga 10 mg film-coated tablets

Primary endpoint: For the primary endpoint, we assume a mean sum between the natriuresis in 24 hours and the daily peritoneal dialytic sodium removal of 122 mEq. Treatment is estimated to increase values by an average of 15% to 140 mEq after treatment. Standard deviation from pretreatment and post treatment is 30 mEq. Assuming a two-sided paired t-test with alfa error of 0.05, power of 80% correlation between pre-post treatment of 0.7 and drop-out rate of 25%, the total sample size required is 30 patients.

Source: https://euclinicaltrials.eu/ctis-public/view/2023-505571-78-00